EU clinical trial 2024-518061-10-00: Psilocybin-Assisted Therapy for Severe Alcohol Use Disorder: Feasibility, Clinical Efficacy & (Neuro)Cognitive Mechanisms
Sponsor: Association Hospitaliere De Bruxelles Et De Schaerbeek Centre Hospitalier Universitaire Brugmann (Hospital/Clinic/Other health care facility). Phase: Therapeutic exploratory (Phase II). Countries: Belgium (ongoing, recruiting).
Therapeutic area(s): Psychiatry and Psychology [F] - Mental Disorders [F03]
Gender: Female, Male. Age: 18-64 years, 65+ years. Enrolment: 62.
Status: Ongoing, recruiting. Start date (EU): 2023-09-13. Decision date: 2025-01-29. Results received: No. Last updated: 2025-11-21.

Condition(s): Severe Alcohol Use Disorder
Product: PCB2: Maltodextrin NF grade, PEX010 Psilocybin Capsules (5mg psilocybin), PEX010 Psilocybin Capsules (25mg psilocybin)

Primary endpoint: Primary clinical outcome: alcohol consumption in terms of changes in the percentage of heavy drinking days from baseline to four weeks posthospital discharge, measured with the timeline follow-back method. Self-reported alcohol consumption data will be corroborated with the surrogate outcome blood phosphatidyl-ethanol concentration at four weeks post-hospital discharge. Primary feasibility and safety outcome: recruitment rate and retention (feasibility), adverse events (safety).
Endpoint(s): Alcohol consumption: - changes in terms of percent heavy drinking days and drinks per days, from baseline to six months post-hospital discharge. Percent days abstinent, from hospital discharge to six months post-hospital discharge, measured with the timeline follow-back method, (Neuro)cognitive measures: - EEG-derived auditory long-term potentiation (neuroplasticity). - EEG-derived-alcohol cue reactivity and inhibition. - Brief Evaluation of Alcohol-Related Neuropsychological Impairments, Acute Psychedelic Effects: - The Revised Mystical Experience Questionnaire-30 items, - The Acceptance/Avoidance-Promoting Experiences Questionnaire, - The Helioscope Questionnaire, - A 20-item Monitor Rating Scale., Psychological Processes: - The Acceptance and Action Questionnaire II (psychological flexibility), - The Multidimensional Assessment of Interoceptive Awareness Scale (interoception), - The Watts Connectedness Scale (connectedness)., Alcohol-related parameters: - Penn Alcohol Craving Scale (craving), - Alcohol Abstinence Self-Efficacy Scale (abstinence self-efficacy), - Readiness rulers (motivation to change drinking behaviour)., Additional clinical outcomes: - Beck Depression Inventory (depressive symptoms), - State-Trait Anxiety Inventory (anxiety symptoms), - Substance Use Recovery Evaluator (substance use recovery), - International Trauma Questionnaire (Subsyndromal trauma symptoms)., Expectancy and blinding: - Blinding efficacy (belief of treatment arm allocation, therapist and participant), - Stanford Expectations of Treatment Scale (expectancy)., Therapeutic alliance: - Working Alliance Inventory-Short Revised., Treatment Satisfaction: - Visual Analog Scale., Qualitative outcomes: - Three semi-structured interviews to explore the evolution of participants' expectations, representations and motivation regarding PATh, as well as characterize participant's experience of PATh within the context of an inpatient detoxification program, and processes of changes in terms of changes in attitudes towards drinking, the self, others and the world; and resulting behavioral changes

Source: https://euclinicaltrials.eu/ctis-public/view/2024-518061-10-00